EU clinical trial 2026-525221-21-01: Optimising Arthritis Strategies in Elderly patients (≥70 years) with rheumatoid arthritis in sustained low disease activity (the OASE study): A Prospective Target Trial Emulation Study Evaluating Tapering of Disease-Modifying Anti-Rheumatic Drugs vs. Usual Care Based on Patient Preference
Sponsor: Aalborg University Hospital (Hospital/Clinic/Other health care facility). Phase: Therapeutic use (Phase IV). Countries: Denmark (authorised, recruitment pending).
Therapeutic area(s): Diseases [C] - Musculoskeletal Diseases [C05]
Gender: Female, Male. Age: 65+ years. Enrolment: 180.
Status: Authorised, recruitment pending. Decision date: 2026-07-06. Results received: No. Last updated: 2026-07-06.

Condition(s): Rheumatoid arthritis
Product: Jyseleca 200 mg film-coated tablets, Olumiant 4 mg film-coated tablets, INFLIXIMAB, CERTOLIZUMAB PEGOL, HYDROXYCHLOROQUINE, RINVOQ 15 mg prolonged-release tablets, ADALIMUMAB, SULFASALAZINE, SARILUMAB, RoActemra 162 mg solution for injection in pre-filled syringe., METHOTREXATE, GOLIMUMAB, ORENCIA 250 mg powder for concentrate for solution for infusion, Prednisolone 5mg Soluble Tablets, XELJANZ 5 mg film-coated tablets, METHOTREXATE, LEFLUNOMIDE, ETANERCEPT, RoActemra 20 mg/mL concentrate for solution for infusion, ORENCIA 125 mg solution for injection in pre-filled syringe

Primary endpoint: 24 months
Endpoint(s): Year 5

Source: https://euclinicaltrials.eu/ctis-public/view/2026-525221-21-01